EU clinical trial 2023-506861-76-00: A Phase III, Open-Label, Randomized Study to Evaluate the Efficacy and Safety of Adjuvant Alectinib Versus Adjuvant Platinum-Based Chemotherapy in Patients with Completely Resected Stage Ib (Tumors ≥ 4 Cm) to Stage IIIa Anaplastic Lymphoma Kinase-Positive Non-Small-Cell Lung Cancer
Protocol code: BO40336
Sponsor: F. Hoffmann-La Roche AG (Pharmaceutical company). Phase: Therapeutic confirmatory (Phase III). Countries: Romania (ongoing, recruitment ended), Denmark (ongoing, recruitment ended), Spain (ongoing, recruitment ended), Austria (ongoing, recruitment ended), Hungary (ongoing, recruitment ended), France (ongoing, recruitment ended), Germany (ongoing, recruitment ended), Poland (ongoing, recruitment ended), Italy (ongoing, recruitment ended), Greece (ongoing, recruitment ended).
Therapeutic area(s): Diseases [C] - Neoplasms [C04]
Gender: Female, Male. Age: 18-64 years, 65+ years. Enrolment: 55.
Status: Ongoing, recruitment ended. Start date (EU): 2018-08-09. Decision date: 2024-05-21. Results received: No. Last updated: 2026-04-06.
Decision dates by country: GR: 2024-08-07, AT: 2024-05-29, IT: 2024-05-28, HU: 2024-05-21, ES: 2024-05-21, PL: 2024-05-27, DK: 2024-05-21, DE: 2024-05-27, FR: 2024-05-24, RO: 2024-05-24

Condition(s): Completely resected, Stage Ib (tumors ≥ 4 cm) to Stage IIIa, Anaplastic Lymphoma Kinase (ALK)-Positive Non-Small Cell Lung Cancer (NSCLC)
Product: Alecensa 150 mg hard capsules, VINORELBINE, Gemcitabin-GRY 1000 mg Pulver zur Herstellung einer Infusionslösung, Carboplatin-GRY® 10 mg/ml Konzentrat zur Herstellung einer Infusionslösung, Carboplatin ACTAVIS 10 mg/ml concentrat pentru soluţie perfuzabilă, ALIMTA 500 mg powder for concentrate for solution for infusion, Cisplatin NeoCorp 1 mg/ml - Konzentrat zur Herstellung einer Infusionslösung, Alecensa 150 mg hard capsules

Primary endpoint: 1. Disease-free survival per investigator’s assessment
Endpoint(s): 1. Overall survival, 2. Incidence of adverse events, with severity determined through use of National Cancer Institute Common Terminology Criteria for Adverse Events version 5.0, 3. Incidence of abnormal laboratory findings, 4. Changes in vital signs and electrocardiograms, 5. Plasma concentrations of alectinib and its major metabolite(s) at specified timepoints for alectinib

Source: https://euclinicaltrials.eu/ctis-public/view/2023-506861-76-00